EU clinical trial 2023-508069-34-01: Biomarkers for the prediction of individual CRSwNP patients' responses to mepolizumab
Sponsor: Amsterdam UMC (Hospital/Clinic/Other health care facility). Phase: Therapeutic use (Phase IV). Countries: Netherlands (ongoing, recruiting).
Therapeutic area(s): Diseases [C] - Otorhinolaryngologic Diseases [C09]
Gender: Female, Male. Age: 18-64 years, 65+ years. Enrolment: 70.
Status: Ongoing, recruiting. Start date (EU): 2024-08-05. Decision date: 2024-06-03. Results received: No. Last updated: 2024-06-03.

Condition(s): Chronic rhinosinusitis with nasal polyps (CRSwNP)
Product: Nucala 100 mg solution for injection in pre-filled pen

Primary endpoint: Identification of cell/molecular biomarkers correlated with individual patients’ responses. These could be: frequencies of cell (sub)populations, gene expression pattern, cell activation statues/phenotype, expression/production pattern of cell products, Identification of immunological mechanisms behind responses to mepolizumab, Evidence for the effectiveness in in vitro setting of mepolizumab in certain CRSsNP patients / endotypes
Endpoint(s): For CRSwNP group: Change in SNOT-22 from baseline to 6 months post-treatment

Source: https://euclinicaltrials.eu/ctis-public/view/2023-508069-34-01